EU clinical trial 2023-506299-28-00: Effect of nonsteroidal anti-inflammatory drugs in the management of postoperative pain after cardiac surgery: A multicentre, randomised, placebo-controlled trial
Sponsor: Centre Hospitalier Universitaire Amiens Picardie (Hospital/Clinic/Other health care facility). Phase: Therapeutic use (Phase IV). Countries: France (ongoing, recruiting).
Therapeutic area(s): Diseases [C] - Cardiovascular Diseases [C14]
Gender: Female, Male. Age: 18-64 years, 65+ years. Enrolment: 238.
Status: Ongoing, recruiting. Start date (EU): 2024-12-02. Decision date: 2024-03-27. Results received: No. Last updated: 2025-07-16.

Condition(s): Postoperative pain after cardiac surgery
Product: NEFOPAM, KETOPROFEN, TRAMADOL, PARACETAMOL, SODIUM CHLORIDE

Primary endpoint: Postoperative pain at rest will be assessed at 24 hours using a numerical rating scale (NRS) graded from 0 to 10
Endpoint(s): During chest physiotherapy, postoperative pain will be assessed as for the primary endpoint using the NRS, Postoperative pain every day from the 1st to the 7th day between 8 a.m. and 12 p.m. as for the primary endpoint using the EN and the pain trajectory will be assessed taking into account the NRS between day 3 and day 7, Nausea will be recorded according to a verbal scale (none, moderate, severe), postoperative pulmonary complications will be looked for in the first 7 days after surgery according to the European consensus definitions, Chronic pain will be assessed at 48 hours and at 3 months by completing a concise pain questionnaire using the DN4 scale, Neuropathic pain will be assessed at 48 hours, Quality of life at 3 months will be assessed by the quality of life scale of the EQ-5D-5L questionnaire compared to the assessment the day before surgery

Source: https://euclinicaltrials.eu/ctis-public/view/2023-506299-28-00